EU clinical trial 2025-520790-39-00: CLonE-specific CAR T-Cell therapy in relapsed or refractory AL amyloidosis - a single-center Phase I trial (CLEAR AL)
Sponsor: Universitaetsklinikum Heidelberg AöR (Hospital/Clinic/Other health care facility). Phase: Human Pharmacology (Phase I)- Other. Countries: Germany (ongoing, recruiting).
Therapeutic area(s): Diseases [C] - Immune System Diseases [C20]
Gender: Female, Male. Age: 18-64 years, 65+ years. Enrolment: 7.
Status: Ongoing, recruiting. Start date (EU): 2026-03-04. Decision date: 2025-11-25. Results received: No. Last updated: 2025-11-25.

Condition(s): relapsed or refractory AL amyloidosis

Source: https://euclinicaltrials.eu/ctis-public/view/2025-520790-39-00